EU clinical trial 2024-514083-31-00: INTERACT-ION : Ezabenlimab (BI 754091) and mDCF (docetaxel, cisplatin and 5-fluorouracil) followed by chemoradiotherapy in patients with stage III squamous cell anal carcinoma. A phase II study.
Sponsor: Centre Hospitalier Regional Universitaire (Hospital/Clinic/Other health care facility). Phase: Therapeutic exploratory (Phase II). Countries: France (ongoing, recruiting).
Therapeutic area(s): Diseases [C] - Digestive System Diseases [C06]
Gender: Female, Male. Age: 18-64 years, 65+ years. Enrolment: 55.
Status: Ongoing, recruiting. Start date (EU): 2024-07-26. Decision date: 2024-07-26. Results received: No. Last updated: 2024-07-26.

Condition(s): squamous cell anal carcinoma
Product: MITOMYCIN, FLUOROURACIL, Ezabenlimab, CAPECITABINE, DOCETAXEL, CISPLATIN

Primary endpoint: the Clinical complete response (cCR) 40 weeks from the treatment initiation (the best time to evaluate the local response is 26 weeks from the commencement of standard CRT
Endpoint(s): 1. Major pathological response: complete response (pCR)/ near-complete response (pnCR) after induction treatment, 2. Biological complete response (bCR) after radiotherapy measured by E6/E7 ctDNA monitoring as previously reported by our team, 1. Objective response rate (ORR) evaluated by RECIST criteria v1.1 (Appendix 1). ORR is defined as the addition of complete response (CR) and partial response (PR) rates. Disease control rate is defined as the addition of ORR and SD (stable disease)., 2. Overall survival (OS). OS is defined as the time between the date of the treatment initiation and death from any cause. Alive patients will be censored at the last date known to be alive, either during study treatment period or during follow-up period., 3. Biological complete response (bCR). bCR is defined as non-detectable HPV ctDNA., 4. Progression-Free Survival (PFS). PFS is defined as the length of time from the date of treatment inititation to the disease progression or death from any cause, whichever occurs first. Alive patients without progression will be censored at the last tumor assessment, either during study treatment period or during follow-up period., 5. Recurrence-free survival (RFS) or disease-free survival (DFS). RFS/DFS is defined as the lengh of time from the date of the end of the radiotherapy to local recurrence and/or metastases or death irrespective of cause and censored at the date of last tumor assessment., 6. Health-related Quality of Life (HRQoL) assessment. HRQoL will be assessed by the EORTC QLQ-C30 at baseline, at evaluation visits, at the end of treatment visit, at the end-point visit, and at follow-up visit., 7. Safety. Safety will be assessed during the study by evaluation of adverse events (AEs) and serious AEs (SAEs), clinical safety laboratory tests, vital signs, and physical examinations according to NCI-CTCAE criteria version 5.0., 8. PET-CT complete response (PET-CR). PET-CR is defined as the absence of pathological hypercaptation. PET-CR will be correlated to cCR, DFS and PFS end-points.

Source: https://euclinicaltrials.eu/ctis-public/view/2024-514083-31-00